EU clinical trial 2023-506942-22-01: Early immunotherapy with intravenous immunoglobulin, cyclophosphamide and methylprednisolone in patients with anti-Hu-associated paraneoplastic sensory neuropathy (NESPA).
Protocol code: APHP230701
Sponsor: Assistance Publique Hopitaux De Paris (Hospital/Clinic/Other health care facility). Phase: Therapeutic exploratory (Phase II). Countries: France (ongoing, recruiting).
Therapeutic area(s): Diseases [C] - Nervous System Diseases [C10]
Gender: Female, Male. Age: 18-64 years, 65+ years. Enrolment: 21.
Status: Ongoing, recruiting. Start date (EU): 2025-01-10. Decision date: 2024-03-18. Results received: No. Last updated: 2025-04-23.

Condition(s): paraneoplastic sensory neuropathy with anti-Hu antibodies
Product: CLAIRYG 50 mg/ml, solution pour perfusion, MESNA EG 100 mg/ml, solution injectable pour perfusion, CYCLOPHOSPHAMIDE SANDOZ 1000 mg, poudre pour solution injectable ou pour perfusion, SOLUMEDROL 1 g, poudre et solvant pour solution injectable

Primary endpoint: Percentage of patients with clinical improvement on the Overall Neuropathy Limitations Scale (ONLS) at 3 months
Endpoint(s): Percentage of patients with clinical improvement on the ONLS scale at 3 and 6 months, Percentage of patients with improvement of the ataxic component on the Score of Ataxia scale at 3 and 6 months, Percentage of patients with improvement in neuropathic pain on the Numeric Rating Scale (NRS) at 3 and 6 months, Percentage of patients with functional improvement on the modified Rankin Score (mRS) at 3 and 6 month, Percentage of patients with functional improvement on the Barthel Index (BI) at 3 and 6 months, Percentage of patients alive and without tumour progression at 6 months, Tolerability of treatment will be assessed by the frequency and severity of expected and unexpected adverse events recorded during treatment.

Source: https://euclinicaltrials.eu/ctis-public/view/2023-506942-22-01